EU clinical trial 2024-511437-35-00: GRAALL 2024 - A 3-cohort Randomized Study evaluating the role of New Immunotherapeutic Agents and of Allogeneic Hematopoietic Stem Cell Transplantation (HSCT) in Frontline Therapy of Adults with Acute Lymphoblastic Leukemia
Sponsor: Assistance Publique Hopitaux De Paris (Hospital/Clinic/Other health care facility). Phase: Phase II and Phase III (Integrated). Countries: Belgium (ongoing, recruiting), France (ongoing, recruiting).
Therapeutic area(s): Diseases [C] - Hemic and Lymphatic Diseases [C15]
Gender: Female, Male. Age: 18-64 years, 65+ years. Enrolment: 1100.
Status: Ongoing, recruiting. Start date (EU): 2026-01-05. Decision date: 2024-10-25. Results received: No. Last updated: 2026-07-22.
Decision dates by country: FR: 2024-10-25, BE: 2025-01-27

Condition(s): Patients aged 18-65 years old with newly diagnosed previously untreated ALL or T-LL.
Product: SARCLISA 20mg/mL concentrate for solution for infusion., SARCLISA 20mg/mL concentrate for solution for infusion., BLINCYTO 38.5 micrograms powder for concentrate and solution for solution for infusion., Iclusig 15 mg film-coated tablets

Primary endpoint: • GRAALL-2024/B o HR patients (phase 3) :OS o SR patients (phase 2) : OS • GRAALL-2024/T (phase 3) : EFS • GRAAPH-2024 (phase 3) : OS
Endpoint(s): • OS and RFS in the T-ALL cohorts, • EFS and RFS in the Phneg/pos ALL cohorts, • Hematological CR rate, • MRD response (IG/TR and BCR::ABL1 markers) after each treatment cycles, • Early mortality at day 30, 60 and 90, • Cumulative incidence of relapse (CIR) and cumulative incidence of non-relapse mortality (CINRM), • Transplant-related mortality (TRM) and graft-versus-host-disease (GvHD) incidence., • Safety: number and rate of patients who experience one or more AEs/SAEs Quality-of-Life measured by the generic EQ5D 5L instrument Incremental cost effectiveness and cost utility ratio defined as the difference in total costs divided by the difference in survival and in quality adjusted life years, Sensitivity analyses: • EFS/RFS, CIR, CINRM and OS after censoring patients receiving allo-HSCT in first remission at transplant time, Sensitivity analyses: • EFS/RFS, CIR, CINRM and OS after censoring outcomes at the time of initiation of any subsequent anti-leukemic therapy other than therapies planned in the protocol, Subgroup analyses: • Age subgroups (older than 45y, 55y), Subgroup analyses: • ALL subgroups according to genomic classification and antigen target expression

Source: https://euclinicaltrials.eu/ctis-public/view/2024-511437-35-00